EU clinical trial 2024-513195-18-00: REVERT : REVErsing airway Remodelling with Tezepelumab : a protocol for a double blind randomized controlled trial for patients with asthma
Protocol code: RECHMPL22_0123
Sponsor: Centre Hospitalier Universitaire De Montpellier (Hospital/Clinic/Other health care facility). Phase: Therapeutic confirmatory (Phase III). Countries: France (ended).
Therapeutic area(s): Diseases [C] - Respiratory Tract Diseases [C08]
Gender: Female, Male. Age: 18-64 years, 65+ years. Enrolment: 150.
Status: Ended. Start date (EU): 2023-03-27. End date (EU): 2026-06-23. Decision date: 2024-07-16. Results received: No. Last updated: 2025-02-20.

Condition(s): Severe asthma
Product: Tezspire 210 mg solution for injection in pre-filled syringe, Matching placebo for tezepelumab solution for injection

Primary endpoint: Comparaison on CT-scan in the change in mean percentage bronchial wall area (%WA) at the B1 and B8 bronchi, generations 3, 4 and 5 between baseline and 6 months
Endpoint(s): Comparaison on CT-scan the change in mean %WA between arms between baseline and 12 months, Comparaison on CT-scan in the average percentage bronchia wall thickness index (%WT) at the B1 and B8 bronchi, generations 3, 4 and 5 between baseline and 6 months, Comparaison on CT-scan in the average percentage bronchia wall thickness index (%WT) at the B1 and B8 bronchi, generations 3, 4 and 5 between baseline and 12 months, Comparaison on CT-scan the change in wall area at the B1 and B8 bronchi, generations 3, 4 and 5 between baseline and 6 months, Comparaison on CT-scan the change in lumen area at the B1 and B8 bronchi, generations 3, 4 and 5 between baseline and 6 months, Comparaison on CT-scan the change in ratio wall area (WA) / lumen area(LM) at the B1 and B8 bronchi, generations 3, 4 and 5 between baseline and 6 months, Comparaison on CT-scan the change in lumen diameter at the B1 and B8 bronchi, generations 3, 4 and 5 between baseline and 6 months, Comparaison on CT-scan the change in lumen circularity at the B1 and B8 bronchi, generations 3, 4 and 5 between baseline and 6 months, Comparaison on CT-scan in the average percentage bronchial wall area(%WA) corrected by body surface area(BSA) at the B1 and B8 bronchi, generations 3, 4 and 5 between baseline and 6 months, Comparaison on CT-scan in the average percentage bronchial wall thickness (%WT) corrected by body surface area (BSA) at the B1 and B8 bronchi, generations 3, 4 and 5 between baseline and 6 months, Change in the expiratory to inspiration ratio of mean lung density (MLDe/i) at Baseline, 6 months and 12 months, Quantitative computed tomography measurements to evaluate airflow obstruction at Baseline, 6 months and 12 months, Change in Total small Airway Count (TAC) between Baseline and 6 months, Change in Total small Airway Count (TAC) between Baseline and 12 months, Change in Lund Mackay score between Baseline and 6 months, Change in Lund Mackay score between Baseline and 12 months, Change in Presence/absence of nasal polyposis between Baseline and 6 months, Change in Presence/absence of nasal polyposis between Baseline and 12 months, Change in Annualized exacerbation rates between Baseline and 12 months, Change in Days alive and not exacerbating between Baseline and 12 months, Change in Days alive and not hospitalized between Baseline and 12 months, Change in forced expiratory volume in 1 second between Baseline and 6 months, Change in forced expiratory volume in 1 second between Baseline and 12 months, Change in forced vital capacity between Baseline and 6 months, Change in forced vital capacity between Baseline and 12 months, Change in forced expiratory volume in 1 second / forced vital capacity Ratio between Baseline and 6 months, Change in forced expiratory volume in 1 second / forced vital capacity Ratio between Baseline and 12 months, Change in total lung capacity between Baseline and 6 months, Change in total lung capacity between Baseline and 12 months, Change in residual volume between Baseline and 6 months, Change in residual volume between Baseline and 12 months, Change in total lung capacity (TLC)/ residual volume(RV) ratio between Baseline and 6 months, Change in total lung capacity (TLC)/ residual volume(RV) ratio between Baseline and 12 months, Change in mean ACQ (Asthma Control Questionnaire)-6 score between Baseline and 6 months, Change in mean ACQ (Asthma Control Questionnaire)-6 score between Baseline and 12 months, Change in Breathlessness, Cough and Sputum Scale (BCSS) between Baseline and 6 months, Change in Breathlessness, Cough and Sputum Scale (BCSS) between Baseline and 12 months, Change in Sino Nasal Outcome Test 22 between Baseline and 6 months, Change in Sino Nasal Outcome Test 22 between Baseline and 12 months, Change in St George Respiratory Questionnaire (SGRQ) between Baseline and 6 months, Change in St George Respiratory Questionnaire (SGRQ) between Baseline and 12 months, Change in ECRHS III Main Questionnaire between Baseline and 6 months, Change in ECRHS III Main Questionnaire between Baseline and 12 months, Changes in serum Club cell secretory protein (CCSP) between baseline and 6 months, Changes in serum Club cell secretory protein (CCSP) between baseline and 12 months, Number of adverse event between arms between baseline and 6 months

Source: https://euclinicaltrials.eu/ctis-public/view/2024-513195-18-00